EU clinical trial 2022-502157-33-00: A Dose Escalation and Expansion Study of BGB-16673 in Patients with B Cell Malignancies
Protocol code: BGB-16673-101
Sponsor: BeOne Medicines AG (Pharmaceutical company). Phase: Phase I and Phase II (Integrated)- First administration to humans. Countries: France (ongoing, recruiting), Germany (ongoing, recruiting), Sweden (ongoing, recruiting), Italy (ongoing, recruiting), Spain (ongoing, recruiting).
Therapeutic area(s): Diseases [C] - Neoplasms [C04]
Gender: Female, Male. Age: 18-64 years, 65+ years. Enrolment: 288.
Status: Ongoing, recruiting. Start date (EU): 2023-09-18. Decision date: 2023-07-11. Results received: No. Last updated: 2026-08-04.
Decision dates by country: IT: 2023-07-11, DE: 2023-07-13, FR: 2023-07-17, SE: 2023-07-13, ES: 2023-07-17

Condition(s): B-Cell Malignancies

Source: https://euclinicaltrials.eu/ctis-public/view/2022-502157-33-00